EU clinical trial 2022-501590-39-00: A study of ASP3082 in adults with advanced solid tumors
Protocol code: 3082-CL-0101
Sponsor: Astellas Pharma Inc (Pharmaceutical company). Phase: Human Pharmacology (Phase I)- First administration to humans. Countries: Spain (ongoing, recruiting), France (ongoing, recruiting).
Therapeutic area(s): Diseases [C] - Neoplasms [C04]
Gender: Female, Male. Age: 18-64 years, 65+ years. Enrolment: 90.
Status: Ongoing, recruiting. Start date (EU): 2024-05-22. Decision date: 2023-11-17. Results received: No. Last updated: 2026-07-21.
Decision dates by country: FR: 2023-11-22, ES: 2023-11-17

Condition(s): Solid Tumor

Source: https://euclinicaltrials.eu/ctis-public/view/2022-501590-39-00